EU clinical trial 2023-509511-84-00: A Phase Ib/II, Multicenter Study of the Combination of LEE011 and BYL719 With Letrozole in Adult Patients With Advanced ER+ Breast Cancer
Protocol code: CLEE011X2107
Sponsor: Novartis Pharma AG (Pharmaceutical company). Phase: Phase I and Phase II (Integrated)- Other. Countries: France (ended), Spain (ongoing, recruitment ended).
Therapeutic area(s): Diseases [C] - Neoplasms [C04]
Gender: Female. Age: 18-64 years, 65+ years. Enrolment: 83.
Start date (EU): 2014-03-19. Decision date: 2024-04-30. Results received: No. Last updated: 2026-02-24.
Decision dates by country: FR: 2024-05-03, ES: 2024-04-30

Condition(s): Advanced HR+ breast cancer
Product: ALPELISIB, RIBOCICLIB, LETROZOLE, LEE011, ALPELISIB, LEE011

Primary endpoint: Incidence of Dose Limiting Toxicities (DLTs) in Cycle 1 - Phase lb only [Time Frame: 28 days], Adverse Events (AEs), serious AEs (SAEs), changes in hematology and chemistry values, vital signs, electrocardiograms (ECGs), dose interruptions, reductions and dose intensity., Plasma concentration-time profiles of LEE011, letrozole. PK parameters, including but not limited to AUC0-24h, Cmin, Cmax, Tmax, accumulation ratio (Racc).
Endpoint(s): Plasma concentration-time profiles of LEE011, BYL719 and letrozole. PK parameters, including but not limited to AUC0-24h, Cmin, Cmax, Tmax, accumulation ratio (Racc)., Tumor response per RECIST v1.1 (by local investigator assessment): Overall Response Rate (ORR), Disease Control Rate (DCR), Clinical benefit Rate (CBR), Duration of Response (DOR) and Progression Free Survival (PFS) CBR is defined as CR, PR, or SD lasting 24 weeks or longer., Incidence of grade 3 or 4 hyperglycemia, Incidence of grade 3 or 4 AST/ALT elevations

Source: https://euclinicaltrials.eu/ctis-public/view/2023-509511-84-00